EU clinical trial 2023-509864-96-00: Acalabrutinib and rituximab in elderly patients with untreated mantle cell lymphoma (ALTAMIRA)
Protocol code: NLG-MCL8
Sponsor: Region Skane (Hospital/Clinic/Other health care facility). Phase: Therapeutic exploratory (Phase II). Countries: Finland (ongoing, recruitment ended), Norway (ongoing, recruitment ended), Denmark (ongoing, recruitment ended), Sweden (ongoing, recruitment ended).
Therapeutic area(s): Diseases [C] - Hemic and Lymphatic Diseases [C15]
Gender: Female, Male. Age: 18-64 years, 65+ years. Enrolment: 80.
Status: Ongoing, recruitment ended. Start date (EU): 2021-12-07. Decision date: 2024-09-04. Results received: No. Last updated: 2026-05-22.
Decision dates by country: FI: 2024-09-04, DK: 2024-09-10, SE: 2024-09-05, NO: 2024-09-12

Condition(s): Mantle Cell Lymphoma (MCL)
Product: ACALABRUTINIB

Primary endpoint: Progression-free survival. This is defined as the interval between date of obtaining informed consent and date of documented progression, first relapse, or death of any cause. Otherwise, patients will be censored at the last date they were known to be alive.
Endpoint(s): Complete response rate at 6 months, Molecular remission rate (MRR) by PCR, Overall response rate, Progression-free survival (median), Response duration (median), Duration of molecular remission (median), Overall survival (median), CR, MRR and ORR in TP53-mutated MCL, Safety, in terms of all grade 3-5 AE

Source: https://euclinicaltrials.eu/ctis-public/view/2023-509864-96-00